EU clinical trial 2024-516842-21-00: MITO 35b Olaparib beyond progression compared to platinum chemotherapy after secondary cytoreductive surgery in recurrent ovarian cancer patients. The phase III randomized, open label MITO 35b study: a project of the MITO-MANGO groups.
Sponsor: IRCCS Istituto Nazionale Tumori Fondazione Pascale (Hospital/Clinic/Other health care facility). Phase: Therapeutic confirmatory (Phase III). Countries: Italy (ongoing, recruiting).
Therapeutic area(s): Diseases [C] - Neoplasms [C04]
Gender: Female. Age: 18-64 years, 65+ years. Enrolment: 200.
Status: Ongoing, recruiting. Start date (EU): 2025-01-09. Decision date: 2025-01-09. Results received: No. Last updated: 2026-06-10.

Condition(s): Recurrent ovarian cancer
Product: DOXORUBICIN, CISPLATIN, PACLITAXEL, CARBOPLATIN, Lynparza 150 mg film-coated tablets, Lynparza 100 mg film-coated tablets, GEMCITABINE, BEVACIZUMAB

Primary endpoint: 1)progression-free survival 2) progression-free survival 2
Endpoint(s): 1) Overall Survival 2) Safety and tolerability (CTCAE 5.0 version and PRO-CTCAE questionnaire) 3) Quality of Life (EORTC QLQ-C30 questionnaire) 4) Financial toxicity (PROFFIT questionnaire

Source: https://euclinicaltrials.eu/ctis-public/view/2024-516842-21-00